EU clinical trial 2023-507973-16-00: A research study looking into the effect of NNC05190130 on blood levels of a birth control pill and emptying of the stomach in women after menopause
Protocol code: NN9541-4922
Sponsor: Novo Nordisk A/S (Pharmaceutical company). Phase: Human Pharmacology (Phase I)- Other. Countries: Germany (ended).
Therapeutic area(s): Diseases [C] - Nutritional and Metabolic Diseases [C18]
Gender: Female. Age: 18-64 years, 65+ years. Enrolment: 37.
Status: Ended. Start date (EU): 2024-07-04. End date (EU): 2025-09-30. Decision date: 2024-06-27. Results received: No. Last updated: 2025-10-10.
Decision dates by country: DE: 2024-08-23

Condition(s): Healthy postmenopausal females (Type 2 Diabetes)

Source: https://euclinicaltrials.eu/ctis-public/view/2023-507973-16-00